EU clinical trial 2023-503247-34-00: A Phase 3 Study to Evaluate Efficacy and Safety of a Single Dose of Exa-cel in Subjects with Severe Sickle Cell Disease, βS/βC Genotype
Protocol code: VX21-CTX001-171
Sponsor: Vertex Pharmaceuticals Inc. (Pharmaceutical company). Phase: Therapeutic confirmatory (Phase III). Countries: Italy (authorised, recruitment pending), France (authorised, recruitment pending).
Therapeutic area(s): Diseases [C] - Congenital, Hereditary, and Neonatal Diseases and Abnormalities [C16]
Gender: Female, Male. Age: 0-17 years, 18-64 years. Enrolment: 5.
Status: Authorised, recruitment pending. Decision date: 2023-10-19. Results received: No. Last updated: 2025-08-19.
Decision dates by country: IT: 2023-10-19, FR: 2024-03-11

Condition(s): Sickle cell anaemia
Product: Mozobil 20 mg/ml solution for injection, Busulfan Fresenius Kabi 6 mg/ml concentrate for solution for infusion, EXAGAMGLOGENE AUTOTEMCEL dispersion for infusion

Primary endpoint: Proportion of subjects who have not experienced any severe vaso-occlusive crises (VOCs) for at least 12 consecutive months (VF12). The duration of VF12 will start 60 days after last red blood cell transfusion for post-transplant support or sickle cell disease management.
Endpoint(s): Safety and tolerability of exa-cel based on adverse events (AEs), clinical laboratory values, neutrophil engraftment, platelet engraftment, transplant-related mortality (TRM), and allcause mortality., Proportion of subjects with HbF level ≥20% at Month 6., Proportion of subjects free from inpatient hospitalization for severe VOCs sustained for at least 12 months (HF12) after exa-cel infusion. The evaluation of HF12 starts 60 days after last RBC transfusion for post-transplant support or SCD disease management., Relative reduction from baseline in annualized rate of severe VOCs up to 24 months after exa-cel infusion., Duration of severe VOC free in subjects who have achieved VF12, Relative reduction from baseline in rate of inpatient hospitalizations for severe VOCs up to 24 months after exa-cel infusion., Relative reduction from baseline in annualized duration of hospitalization for severe VOCs up to 24 months after exa-cel infusion., Proportion of subjects with sustained HbF ≥20% at the time of analysis for at least 3 months, 6 months, or 12 months., Relative reduction from baseline in annualized volume of RBC transfusions, Fetal hemoglobin (HbF) concentration over time, Hemoglobin (Hb) concentration over time, Proportion of subjects with detectable haptoglobin over time, Proportion of alleles with intended genetic modification present in peripheral blood over time, Proportion of alleles with intended genetic modification present in CD34+ cells of the bone marrow over time, Change in patient reported outcomes (PROs) over time in adults (≥18 years) using; o Pain scale: 11-point numerical rating scale (NRS) o Functional assessment of cancer therapy-bone marrow transplant (FACT-BMT) o Adult Sickle Cell Quality of Life Measurement System (ASCQ-Me) o EuroQol Quality of Life Scale (EQ 5D 5L), Change in PROs over time in adolescents (12 to <18 years of age) using; o Pain-scale: 11-point NRS o Pediatric Quality of Life Inventory (PedsQL) Generic Core self-report and parent proxy versions o PedsQL SCD module (self-report and parent proxy versions) o EQ-5D-Youth (EQ-5D-Y self-report and parent proxy versions), Change from baseline in reticulocyte count (percent reticulocytes and absolute reticulocyte count) over time, Change from baseline in hemolysis biomarker concentrations over time: indirect bilirubin, haptoglobin, and lactate dehydrogenase (LDH), Proportion of subjects with normalized LDH

Source: https://euclinicaltrials.eu/ctis-public/view/2023-503247-34-00